EU clinical trial 2024-516737-12-00: Phase II Combination Study of NMS-01940153E and Atezolizumab with or without a prior priming with low dose decitabine for the Treatment of Adult Patients with Unresectable Hepatocellular Carcinoma (HCC) Previously Treated with Immune Checkpoint Inhibitors
Protocol code: MPSA-153-002
Sponsor: Nerviano Medical Sciences S.r.l. (Pharmaceutical company). Phase: Therapeutic exploratory (Phase II). Countries: Spain (ended), Italy (ended).
Therapeutic area(s): Diseases [C] - Neoplasms [C04]
Gender: Female, Male. Age: 18-64 years, 65+ years. Enrolment: 90.
Status: Ended. Start date (EU): 2025-01-28. End date (EU): 2026-04-21. Decision date: 2024-12-19. Results received: Yes. Last updated: 2025-08-19.
Decision dates by country: IT: 2024-12-19, ES: 2024-12-19

Condition(s): Unresectable Hepatocellular Carcinoma (HCC)
Product: Dacogen 50 mg powder for concentrate for solution for infusion., NMS-01940153E, Tecentriq 840 mg concentrate for solution for infusion

Primary endpoint: ORR, calculated as the proportion of evaluable patients who have achieved, as BOR, confirmed CR or PR measured by investigator-assessed RECIST 1.1.
Endpoint(s): Overall safety profile characterized by type, severity (graded using National Cancer Institute CTCAE version 5.0), duration of the adverse events (AEs), laboratory, and electrocardiogram abnormalities, unacceptable toxicities, and relationship of the AEs to study treatment in the first and subsequent cycles of therapy, Duration of response (DOR) as measured by investigator-assessed RECIST 1.1, Progression-free survival (PFS), including landmark analyses, as measured by investigator-assessed RECIST 1.1, Overall survival, Pharmacokinetic parameters of NMS-01940153E and its main metabolite NMS-03593478 in plasma.

Source: https://euclinicaltrials.eu/ctis-public/view/2024-516737-12-00